EU clinical trial 2022-502156-31-00: A phase 1/2 open-label study of Debio 0123 in combination with temozolomide in adult participants with recurrent or progressive glioblastoma and of Debio 0123 in combination with temozolomide and radiotherapy in adult participants with newly diagnosed glioblastoma
Protocol code: Debio 0123-GBM-105
Sponsor: Debiopharm International S.A. (Pharmaceutical company). Phase: Phase I and Phase II (Integrated)- Other. Countries: Spain (ongoing, recruiting).
Therapeutic area(s): Diseases [C] - Neoplasms [C04]
Gender: Female, Male. Age: 18-64 years, 65+ years. Enrolment: 55.
Status: Ongoing, recruiting. Start date (EU): 2023-05-26. Decision date: 2023-04-27. Results received: No. Last updated: 2026-07-31.

Condition(s): Glioblastoma
Product: Temozolomide SUN 140 mg hard capsules, Temozolomide SUN 5 mg hard capsules, TEMOZOLOMIDE, Debio 0123, Temozolomide SUN 180 mg hard capsules, SULFAMETHOXAZOLE AND TRIMETHOPRIM, Debio 0123, TEMOZOLOMIDE, TEMOZOLOMIDE, Temozolomide SUN 20 mg hard capsules, Temozolomide SUN 180 mg hard capsules, Temozolomide SUN 140 mg hard capsules, Temozolomide SUN 250 mg hard capsules, TEMOZOLOMIDE, Debio 0123, Temozolomide SUN 100 mg hard capsules, TEMOZOLOMIDE, Temozolomide SUN 100 mg hard capsules, Temozolomide SUN 5 mg hard capsules, Debio 0123, Temozolomide SUN 20 mg hard capsules, Debio 0123, TEMOZOLOMIDE, Debio 0123, Temozolomide SUN 100 mg hard capsules, Temozolomide SUN 180 mg hard capsules, Temozolomide SUN 140 mg hard capsules, Temozolomide SUN 20 mg hard capsules, Temozolomide SUN 5 mg hard capsules, Temozolomide SUN 250 mg hard capsules

Primary endpoint: Phase 1 (Arms A and B/C): Occurrence of Drug Limiting Toxicities, Phase 1 (Arms A and B/C): Occurrence and severity of TEAEs, serious TEAEs, TEAEs leading to death, and TEAEs leading to treatment discontinuation and/or dose modifications, graded according to NCI-CTCAE, Phase 1 (Arms A and B/C): Laboratory parameters and related severity based on NCI-CTCAE, Phase 1 (Arms A and B): Occurrence of treatment discontinuations and treatment modifications due to TEAEs and laboratory abnormalities, Phase 1 (Arms A and B/C): Changes from baseline in parameters of vital signs, ECG, echocardiogram, and KPS, Phase 1 – dose expansion: Occurrence and severity of TEAEs graded according to NCI- CTCAE 5.0, Phase 1 – dose expansion: OR as per RANO and change from baseline in tumor size, Phase 1 – dose expansion: PDy (change from baseline in pCDC2), Phase 1 – dose expansion: Plasma exposure of Debio 0123 and its metabolite, Phase 2: Overall Survival
Endpoint(s): Phase 1 - Arm A: PK profile and PK parameters of Debio 0123 and its metabolite after repeated dosing including but not limited to: Cmax, Ctrough, tmax, AUClast., Phase 1 - Arm A: PK profile and parameters of TMZ after repeated dosing, including but not limited to: Cmax, AUClast, Ctrough., Phase 1 (Arm A, B/C and dose expansion) and Phase 2: Tumor response according to the RANO criteria: BOR, OR, DC., Phase 1 (Arm A, B/C and dose expansion) and Phase 2: DOR and PFS according to RANO criteria., Phase 1 - Arm B/C: PK profile and PK parameters of Debio 0123 and its metabolite after repeated dosing, including but not limited to: Cmax, Ctrough, tmax, AUClast., Phase 1 - Arm B/C: PK profile and parameters of TMZ, including but not limited to: Cmax, AUClast, Ctrough., Phase 1 dose expansion and phase 2: Occurrence and severity of TEAEs, serious TEAEs, TEAEs leading to death, and TEAEs leading to treatment discontinuation and/or dose modifications, graded according to NCI-CTCAE., Phase 1 dose expansion and phase 2: Laboratory parameters and related severity based on NCI-CTCAE 5.0, Phase 1 dose expansion and phase 2: Occurrence of treatment discontinuations and treatment modifications due to TEAEs and laboratory abnormalities., Phase 1 dose expansion and phase 2: Changes from baseline in parameters of vital signs, ECG, echocardiogram, and KPS., Phase 1 dose expansion: PK parameters of Debio 0123 and its metabolite, including but not limited to Ctrough and AUC, Phase 1 dose expansion: Overall Survival, Phase 2: PK parameters of Debio 0123 and its metabolite as applicable, including but not limited to: Ctrough and AUC

Source: https://euclinicaltrials.eu/ctis-public/view/2022-502156-31-00